EU clinical trial 2024-514934-19-00: An interventional, Phase III, double-blind, randomized, controlled, parallel-group, multi-site, clinical trial evaluating the efficacy and safety of Qutenza® in subjects with post-surgical neuropathic pain
Protocol code: AV001
Sponsor: Averitas Pharma Inc. (Pharmaceutical company). Phase: Therapeutic confirmatory (Phase III). Countries: Netherlands (ended), Spain (ended), Poland (ended), France (ended).
Therapeutic area(s): Phenomena and Processes [G] - Physiological processes [G07]
Gender: Female, Male. Age: 18-64 years, 65+ years. Enrolment: 204.
Status: Ended. Start date (EU): 2021-11-08. End date (EU): 2025-08-28. End date: 2025-08-29. Decision date: 2024-08-13. Results received: No. Last updated: 2024-09-22.
Decision dates by country: FR: 2024-08-20, ES: 2024-08-13, NL: 2024-08-14, PL: 2024-09-22

Condition(s): Post-surgical neuropathic pain
Product: Qutenza 179 mg cutaneous patch, CAPSAICIN, Qutenza 179 mg cutaneous patch

Primary endpoint: Change from baseline to the average score of the entire period between Week 2 and Week 12 in the 24-hr average pain intensity.
Endpoint(s): Change from baseline to Week 12 in the treatment area size., Incidence of treatment-emergent adverse events (TEAEs). Incidence of TEAEs leading to discontinuation in the Core Phase., Change from baseline to the weekly average score of Week 42 in the 24-hr average pain intensity., Change from baseline to Week 42 in the treatment area size., Change from baseline to the average score of the entire period between Week 2 and Week 42 in the 24-hr average pain intensity., Incidence of TEAEs. Incidence of TEAEs leading to discontinuation in the Extension Phase.

Source: https://euclinicaltrials.eu/ctis-public/view/2024-514934-19-00